EU clinical trial 2022-501253-37-00: A Clinical Trial of Pembrolizumab (MK-3475) Evaluating Predictive Biomarkers in Subjects with Advanced Solid Tumors (KEYNOTE-158)
Protocol code: MK-3475-158
Sponsor: Merck Sharp & Dohme LLC (Pharmaceutical company). Phase: Therapeutic exploratory (Phase II). Countries: Netherlands (ongoing, recruitment ended), France (ongoing, recruitment ended), Denmark (ongoing, recruitment ended), Germany (ongoing, recruitment ended), Norway (ongoing, recruitment ended), Italy (ongoing, recruitment ended), Spain (ongoing, recruitment ended), Portugal (ongoing, recruitment ended), Poland (ongoing, recruitment ended).
Therapeutic area(s): Diseases [C] - Neoplasms [C04]
Gender: Female, Male. Age: 18-64 years, 65+ years. Enrolment: 644.
Status: Ongoing, recruitment ended. Start date (EU): 2016-02-02. Decision date: 2023-02-07. Results received: No. Last updated: 2026-08-05.
Decision dates by country: NO: 2023-02-13, DK: 2023-02-08, ES: 2023-02-13, DE: 2023-02-09, PL: 2023-10-23, FR: 2023-02-07, IT: 2023-02-10, NL: 2023-02-08, PT: 2023-10-17

Condition(s): (A) Anal Squamous Cell Carcinoma, (B) Biliary Adenocarcinoma (gallbladder or biliary tree (intrahepatic or extrahepatic cholangiocarcinoma) except Ampulla of Vater cancers); (C) Neuroendocrine Tumors (well- and moderately differentiated) of the lung, appendix, small intestine, colon, rectum, or pancreas, (D) Endometrial Carcinoma (sarcomas and mesenchymal tumors are excluded), (E) Cervical Squamous Cell Carcinoma, (F) Vulvar Squamous Cell Carcinoma, (G) Small Cell Lung Carcinoma, (H) Mesothelioma, (I) Thyroid Carcinoma, (J) Salivary Gland Carcinoma (sarcomas and mesenchymal tumors are excluded), OR (K) Any advanced solid tumor, with the exception of colorectal carcinoma (CRC), which is microsatellite instability (MSI)-high (MSI-H). (L) Any advanced solid tumor (including CRC) which is mismatch repair deficient (dMMR)/MSI-H in subjects from mainland China who are of Chinese descent. (M) Any advanced solid tumor that has failed at least one line of therapy and is Tumor Mutational Burden-High (TMB-H) (≥10 mut/Mb, F1CDx assay), excluding subjects with dMMR/MSI-H tumors.
Product: KEYTRUDA 25 mg/mL concentrate for solution for infusion

Primary endpoint: Objective Response Rate (ORR)
Endpoint(s): Duration of Response (DOR), Progression Free Survival (PFS), Overall Survival (OS), Percentage of Participants with Adverse Events, Percentage of Participants who Discontinued Study Intervention due to Adverse Events

Source: https://euclinicaltrials.eu/ctis-public/view/2022-501253-37-00